EU clinical trial 2023-507065-26-00: A randomized controlled trial to compare the immunogenicity and skin imprinting of intradermal and intramuscular rabies vaccination < RABISKIMM >
Sponsor: Institute Of Tropical Medicine (Hospital/Clinic/Other health care facility). Phase: Therapeutic confirmatory (Phase III). Countries: Belgium (ended).
Therapeutic area(s): Diseases [C] - Virus Diseases [C02]
Gender: Female, Male. Age: 18-64 years. Enrolment: 165.
Status: Ended. End date (EU): 2024-04-29. Decision date: 2024-01-31. Results received: Yes. Last updated: 2024-01-31.

Condition(s): Rabies
Product: Rabipur poeder en oplosmiddel voor oplossing voor injectie in een voorgevulde spuit.Rabiësvaccin (geïnactiveerd).

Primary endpoint: The percentage and absolute number of skin-resident and RABV-specific T cells within the CD3+ lymphocyte parent population after booster vaccination at D120+14, measured by flow cytometry.
Endpoint(s): Percentage and absolute number of circulating and RABV-specific TCM and TEM cells within the CD3+ lymphocyte parent population at D120+14, Percentage and absolute number of increase in RABV-specific TRM, TCM and TEM cells within the CD3+ lymphocyte parent population from D28 to D120+14, Percentage and absolute number of RABV-specific TRM, TCM and TEM CD4+ and CD8+ T cells within the CD3+ lymphocyte parent population at D28 and D120+14, and their percentage and absolute number of increase from D28 to D120+14, The geometric mean titres (GMTs) of neutralizing RRFIT test at D210+14, The nAbs GMT titres, IFNy+ spot forming units (SFU) and IFNy/TNF-a/IL-2+ SFU at D0, D7, D28, D120, D120+14, D120+90, measured by RRFIT and elispot/fluorospot respectively., At all timepoints, the geometric mean titres (GMTs) of neutralizing RRFIT test and IFNy+ spot forming units (SFU) and IFNy/TNF-a/IL-2+ SFU. In addition at D28 and D120+14, the percentage and absolute number of RABV-specific TRM, TCM and TEM cells within the CD3+ lymphocyte parent population.

Source: https://euclinicaltrials.eu/ctis-public/view/2023-507065-26-00